EU clinical trial 2025-520918-64-00: A Phase II Open-Label Pilot Trial Assessing the Safety of Anifrolumab in Adult Patients with Primary Antiphospholipid Syndrome (APS). The AnifAPS trial.
Protocol code: D3461C00035
Sponsor: National And Kapodistrian University Of Athens (Educational Institution). Phase: Therapeutic exploratory (Phase II). Countries: Greece (authorised, recruiting).
Therapeutic area(s): Diseases [C] - Immune System Diseases [C20]
Gender: Female, Male. Age: 18-64 years. Enrolment: 20.
Status: Authorised, recruiting. Start date (EU): 2026-04-24. Decision date: 2025-10-21. Results received: No. Last updated: 2026-05-10.

Condition(s): Primary Antiphospholipid Syndrome (APS)
Product: Anifrolumab

Primary endpoint: Incidence of adverse events (AEs) including adverse events of special interest [AESIs; i.e., opportunistic infections, serious non-opportunistic infections, herpes zoster, influenza, malignancies, anaphylaxis] by week 52
Endpoint(s): Change from baseline (neutralization rate) in type I IFN signature, as assessed by a validated 4-gene panel at weeks 24 and 52, Change from baseline in aCL and aβ2GPI IgG antibody titres and LA status at weeks 12, 24 and 52, Change from baseline in lupus anticoagulant (LA) status at weeks 24 and 52, Change from baseline in complement C3 and C4 levels at weeks 12, 24 and 52, Change from baseline in endogenous thrombin potential, as assessed by a thrombin generation assay at weeks 24 and 52, Change from baseline in the levels of ΝET release markers [i.e., myeloperoxidase (MPO), citrullinated histone H3 (H3Cit) and MPO-deoxyribonucleic acid (DNA) complexes), as assessed by immunofluorescence confocal microscopy and enzyme-linked immunosorbent assay (ELISA) at weeks 24 and 52, Change from baseline in immunothrombosis/thromboinflammation-related gene expression, as assessed by bulk ribonucleic acid (RNA) sequencing at weeks 24 and 52, Change from baseline in the 36-Item Short Form Survey version 2 (SF-36v2) score at weeks 4, 12, 24, 36, 48 and 52, Change from baseline in the Functional Assessment of Chronic Illness Therapy-Fatigue (FACIT-Fatigue) score at weeks 4, 12, 24, 36, 48 and 52, Change from baseline in the Patient Health Questionnaire 9 (PHQ-9) score at weeks 4, 12, 24, 36,.48 and 52, Change from baseline in the Patient’s Global Assessment of health status (PtGA) score at weeks 4, 12, 24, 36, 48 and 52, Change from baseline in the Physician’s Global Assessment of patient’s health status (PhGA) score at weeks 4, 12, 24, 36, 48 and 52, Rate of recurrent venous or arterial thrombotic events within patients with thrombotic APS by week 52, Proportion of patients with livedoid vasculopathy/skin ulcers at baseline achieving CR defined as skin ulcer complete closure as assessed by physical examination, PR defined as ≥50% improvement (wound area reduction) in skin ulcers, and NR defined as no change or worsening of skin ulcers by week 52, Proportion of patients with aPL nephropathy at baseline achieving complete response (CR) defined as proteinuria <800 mg/24h and estimated glomerular filtration rate (eGFR) ≥10% of baseline values, partial response (PR) defined as ≥50% reduction in proteinuria to sub-nephrotic levels (<3 g/24h) and eGFR ≥10% of baseline values, or no response (NR) defined as the absence of CR or PR, at week 52, Proportion of patients with pulmonary haemorrhage at baseline achieving CR defined as resolution of relevant imaging findings in lung computed tomography (lung CT) or absence of relapse by week 52, Proportion of patients with myocardial disease at baseline achieving CR defined as the disappearance of magnetic resonance imaging (MRI) lesions, PR defined as ≥50% improvement in MRI lesions, or NR defined as no change or worsening of MRI lesions by week 52, Proportion of patients with thrombocytopenia at baseline achieving CR defined as a platelet count (PLT) ≥150 x 109/μl, PR defined as 130-149 x 109/μl, or NR defined as <130 x 109/μl at week 52

Source: https://euclinicaltrials.eu/ctis-public/view/2025-520918-64-00